EU clinical trial 2024-517886-18-00: The randomized, double blind study phase III.b of the Comprehensive assessment of the musculoskeletal health in children with cystic fibrosis – on the search for means of improvement
Protocol code: COAM-CFD-01
Sponsor: Fakultni Nemocnice V Motole (Hospital/Clinic/Other health care facility). Phase: Therapeutic confirmatory (Phase III). Countries: Czechia (ongoing, recruiting).
Therapeutic area(s): Diseases [C] - Musculoskeletal Diseases [C05]; Diseases [C] - Respiratory Tract Diseases [C08]
Gender: Female, Male. Age: 0-17 years. Enrolment: 64.
Status: Ongoing, recruiting. Start date (EU): 2024-10-02. Decision date: 2024-10-02. Results received: No. Last updated: 2024-10-02.

Condition(s): Cystic fibrosis and problems with bone metabolism, bone density, skeletal muscle force
Product: Vigantol 0,5 mg/ml perorální kapky, roztok

Primary endpoint: Serum concentrations of 25-OH vitamin D and parathormone at visits V3-V7, Lumbar Spine aBMD at visit V7, Dynamic muscle force and power at visit V7

Source: https://euclinicaltrials.eu/ctis-public/view/2024-517886-18-00